EU clinical trial 2023-503206-37-00: A PHASE III, OPEN-LABEL, MULTICENTER RANDOMIZED STUDY EVALUATING GLOFITAMAB AS A SINGLE AGENT VERSUS INVESTIGATOR’S CHOICE IN PATIENTS WITH RELAPSED/REFRACTORY MANTLE CELL LYMPHOMA
Protocol code: GO43878
Sponsor: F. Hoffmann-La Roche AG (Pharmaceutical company). Phase: Therapeutic confirmatory (Phase III). Countries: Italy (ongoing, recruiting), France (ongoing, recruiting), Sweden (ongoing, recruiting), Spain (ongoing, recruiting).
Therapeutic area(s): Diseases [C] - Neoplasms [C04]; Health Care [N] - Environment and Public Health [N06]
Gender: Female, Male. Age: 18-64 years, 65+ years. Enrolment: 39.
Status: Ongoing, recruiting. Start date (EU): 2023-11-20. Decision date: 2023-10-04. Results received: No. Last updated: 2026-03-17.
Decision dates by country: SE: 2023-10-05, IT: 2023-10-04, ES: 2023-10-06, FR: 2023-10-04

Condition(s): Mantle Cell Lymphoma (MCL)
Product: Bendamustin cell pharm® 2,5 mg/ml Pulver für ein Konzentrat zur Herstellung einer Infusionslösung, Lenalidomide Accord 5 mg hard capsules, Lenalidomide Accord 20 mg hard capsules, Bendamustin Hikma 2,5 mg/ml Pulver für ein Konzentrat zur Herstellung einer Infusionslösung, RoActemra 20 mg/mL concentrate for solution for infusion, Columvi 10 mg concentrate for solution for infusion, Glofitamab, RoActemra 20 mg/mL concentrate for solution for infusion, Lenalidomide Accord 15 mg hard capsules, Bendamustin Baxter 2,5 mg/ml Pulver für ein Konzentrat zur Herstellung einer Infusionslösung, MabThera 500 mg concentrate for solution for infusion, Lenalidomide Accord 10 mg hard capsules, Gazyvaro 1,000 mg concentrate for solution for infusion.

Primary endpoint: PFS as determined by the Blinded independent Review Committee (BIRC)
Endpoint(s): BIRC-assessed CR rate, BIRC-assessed ORR, OS, Time to deterioration in physical functioning and fatigue as assessed by the European Organization for Research and Treatment of Cancer (EORTC) quality of life (QoL)-C30, Investigator-assessed PFS, Investigator-assessed CR rate, Investigator-assessed OR rate, Investigator-assessed DOCR, Investigator-assessed DOR, BIRC-assessed DOCR, BIRC-assessed DOR, Investigator-assessed EFS, Incidence and severity of adverse events, with severity determined according to the National Cancer Institute Common Terminology Criteria for Adverse Events version 5.0 grading scale, except cytokine-release syndrome (CRS), immune effector cell associated neurotoxicity syndrome (ICANS) and hemophagocytic lymphohistiocytosis (HLH) which will be graded using American Society for Transplantation and Cellular Therapy (ASTCT) grading criteria (Lee et al., 2019; Hines et al., 2023, Change from baseline in selected vital signs, Change from baseline in selected clinical laboratory test results, Frequency, severity, and interference of side effects as assessed by the Patient-Reported Outcomes version of the Common Terminology Criteria for Adverse Events (PRO-CTCAE), Proportion of participants reporting each response option for item General Population, Question 5 (GP5) from the Functional Assessment of Cancer Therapy General (FACT-G) at each assessment timepoint by treatment arm, Time to deterioration in lymphoma symptoms, defined as the time from randomization to the first documentation of a 3-point or more decrease in score as assessed by the Functional Assessment of Cancer Therapy Lymphoma Lymphoma Subscale (FACT-Lym LYMS) questionnaire, Proportion of participants experiencing a clinically meaningful improvement (3-point or more increase) in lymphoma symptoms as assessed through use of the FACT-Lym LYMS, Proportion of participants experiencing a clinically meaningful improvement in physical functioning (10-point or more increase) and/or fatigue (10-point or more decrease) as assessed by the EORTC QLQ-C30, Change from baseline in physical functioning, fatigue, and lymphoma symptoms at each cycle as assessed by the European Organisation for Research and Treatment of Cancer (EORTC) QLQ-C30 and FACT-Lym LYMS, Serum concentration of glofitamab at specified timepoints, Prevalence of anti-drug antibodies (ADAs) at baseline and incidence of ADAs during the study

Source: https://euclinicaltrials.eu/ctis-public/view/2023-503206-37-00